EU clinical trial 2023-508814-40-00: Safety, Tolerability, Pharmacokinetics, and Pharmacodynamics of NBI-1117570 in Healthy Adults
Protocol code: NBI-1117570-1769
Sponsor: Neurocrine Biosciences Inc. (Pharmaceutical company). Phase: Human Pharmacology (Phase I)- Other. Countries: Netherlands (ended).
Therapeutic area(s): Diseases [C] - Nervous System Diseases [C10]
Gender: Female, Male. Age: 18-64 years, 65+ years. Enrolment: 122.
Status: Ended. Start date (EU): 2024-03-11. End date (EU): 2025-05-15. Decision date: 2024-02-13. Results received: No. Last updated: 2025-03-14.

Condition(s): Neurological and neuropsychiatric conditions

Source: https://euclinicaltrials.eu/ctis-public/view/2023-508814-40-00